EU clinical trial 2023-505483-11-00: Partial oral antibiotic treatment for bacterial brain abscess: An open-label randomised non-inferiority trial (ORAL)
Sponsor: Aalborg University Hospital (Hospital/Clinic/Other health care facility). Phase: Therapeutic use (Phase IV). Countries: Denmark (ongoing, recruiting), Netherlands (ongoing, recruiting), Sweden (ongoing, recruiting), France (ongoing, recruiting).
Therapeutic area(s): Diseases [C] - Nervous System Diseases [C10]; Diseases [C] - Bacterial Infections and Mycoses [C01]
Gender: Female, Male. Age: 18-64 years, 65+ years. Enrolment: 370.
Status: Ongoing, recruiting. Start date (EU): 2021-05-02. Decision date: 2023-07-28. Results received: No. Last updated: 2025-02-27.
Decision dates by country: FR: 2023-10-02, DK: 2023-07-28, SE: 2023-08-04, NL: 2023-07-28

Condition(s): Brain abscess
Product: Meropenem 2 g powder for solution for injection/infusion, Cefotaxime MIP 1 g, süste-/infusioonilahuse pulber, Moxifloxacin Tillomed 400 mg film coated tablets, LINEZOLIDE VIATRIS 600 mg, comprimé pelliculé, Clindamycin 600 mg Capsules, hard, Flagyl 500 mg κάψουλες, CEFTRIAXONE ARROW 1 g/3,5 ml, poudre et solvant pour solution injectable (IM), AMOXICILLIN

Primary endpoint: 6-month risk of death, rupture of brain abscess, unplanned aspiration or excision of brain abscess, relapse, or recurrence.
Endpoint(s): Occurence of each component of the primary composite endpoint after 6 months since randomisation, All-cause mortality at 3-, 6-, and 12-months after randomisation, Unfavourable outcome at end of treatment as well as 3-, 6-, and 12-months since randomisation using sliding dichotomy of E-GOS stratified by level of comorbidity at time of randomisation, Completion and adherence to assigned treatment strategy, Line complications, Durations of admission and antibiotic treatment for brain abscess, Number of readmissions within 6 months since randomisation, Occurrence of Clostridioides difficile associated diarrhoea during brain abscess treatment, Oedema on cranial imaging at 3 months since randomisation., Severe adverse events during brain abscess treatment, Quality of life scores and cognitive evaluations (SF-36, EQ-5D-5L, MoCA) at time of randomisation, end of treatment and 3-, 6-, and 12-months since randomisation

Source: https://euclinicaltrials.eu/ctis-public/view/2023-505483-11-00